EU clinical trial 2023-509142-35-00: Anticoagulation for Stroke Prevention In patients with Recent Episodes of Atrial Fibrillation occurring transiently with stress - The ASPIRE-AF trial
Protocol code: 2019-ASPIREAF
Sponsor: Hamilton Health Sciences Corporation (Hospital/Clinic/Other health care facility). Phase: Therapeutic use (Phase IV). Countries: Denmark (ongoing, recruiting), Sweden (ongoing, recruiting), Spain (ongoing, recruiting), Netherlands (ongoing, recruiting), Italy (ongoing, recruiting), Finland (ongoing, recruiting), Germany (ongoing, recruiting), Belgium (authorised, recruiting), Greece (authorised, recruiting), Norway (authorised, recruitment pending), France (not authorised).
Therapeutic area(s): Diseases [C] - Cardiovascular Diseases [C14]
Gender: Female, Male. Age: 18-64 years, 65+ years. Enrolment: 969.
Start date (EU): 2024-01-29. Decision date: 2024-01-29. Results received: No. Last updated: 2026-07-23.
Decision dates by country: FI: 2024-11-22, DK: 2024-01-30, NL: 2024-01-29, SE: 2024-01-31, IT: 2024-02-01, ES: 2024-01-30, NO: 2026-03-26, GR: 2025-05-02, BE: 2025-02-14, DE: 2024-12-18

Condition(s): Atrial fibrillation after stress (e.g., noncardiac surgery or acute medical illness)
Product: DABIGATRAN, RIVAROXABAN, APIXABAN, RIVAROXABAN, EDOXABAN, APIXABAN, EDOXABAN

Primary endpoint: Individual components of the co-primary outcomes, All stroke, All-cause mortality

Source: https://euclinicaltrials.eu/ctis-public/view/2023-509142-35-00